EU clinical trial 2024-512715-42-00: The ADAPT Study: An Open-Label, Long-term Safety Study of INZ-701 in Patients with ENPP1 Deficiency and ABCC6 Deficiency
Protocol code: INZ701-304
Sponsor: Inozyme Pharma Inc. (Pharmaceutical company). Phase: Therapeutic exploratory (Phase II). Countries: Germany (ongoing, recruiting), France (ongoing, recruiting).
Therapeutic area(s): Diseases [C] - Musculoskeletal Diseases [C05]
Gender: Female, Male. Age: 0-17 years, 18-64 years, 65+ years. Enrolment: 14.
Status: Ongoing, recruiting. Start date (EU): 2024-10-08. Decision date: 2024-09-30. Results received: No. Last updated: 2025-08-14.
Decision dates by country: DE: 2024-09-30, FR: 2025-01-07

Condition(s): Ectonucleotide Pyrophosphatase/Phosphodiesterase 1 (ENPP1) Deficiency and ATP-binding cassette sub-family C member 6 (ABCC6) Deficiency, Generalized Arterial Calcification of Infancy (GACI), Pseudoxanthoma elasticum (PXE)
Product: INZ-701

Primary endpoint: Incidence, frequency, and severity of adverse events (AEs), treatment-emergent adverse event (TEAEs), adverse events of special interest (AESIs), and serious adverse events (SAEs), Changes in clinical laboratory tests including chemistry, hematology, and urinalysis resulting in an AE, Concomitant medications, Titers of anti-drug antibodies (ADA)
Endpoint(s): INZ-701 plasma PK parameters measured by immunoassay and enzymatic activity, Plasma PPi concentrations based on a validated assay

Source: https://euclinicaltrials.eu/ctis-public/view/2024-512715-42-00